EU clinical trial 2024-510943-76-00: ALBU-CHIP - Efficacy of human 20% albumin solution + Ringer Lactate versus Ringer Lactate for fluid replacement strategy during cytoreductive surgery combined with hyperthermic intraperitoneal chemotherapy : a randomized clinical trial
Protocol code: APHP230864
Sponsor: Assistance Publique Hopitaux De Paris (Hospital/Clinic/Other health care facility). Phase: Therapeutic confirmatory (Phase III). Countries: France (ongoing, recruiting).
Therapeutic area(s): Diseases [C] - Digestive System Diseases [C06]; Diseases [C] - Neoplasms [C04]
Gender: Female, Male. Age: 18-64 years, 65+ years. Enrolment: 140.
Status: Ongoing, recruiting. Start date (EU): 2025-09-03. Decision date: 2025-03-20. Results received: No. Last updated: 2026-05-26.

Condition(s): Cytoreductive surgery with hyperthermic intraperitoneal chemotherapy
Product: VIALEBEX 200 g/L, solution pour perfusion, ELECTROLYTES

Primary endpoint: Comprehensive Complication Index (CCI score) at day 28
Endpoint(s): CCI score at day 7, volume of intra operative and post-operative (48h) post-operative fluid therapy, cumulated incidence of surgical post-operative complications at 28 days, cumulated incidence of infectious post-operative complications at 28 days, cumulated incidence of medical post-operative complications at 28 days, need for mechanical ventilation, renal replacement therapy between surgery and day 28, SOFA score variation between pre-operative period and 48h after surgery, number of days alive out of intensive care unit and out of hospital until day 28, mortality at day 28, Hypersensitivity reactions to albumin at 133 days

Source: https://euclinicaltrials.eu/ctis-public/view/2024-510943-76-00